EU clinical trial 2024-513514-35-00: A Phase I Trial of Memory T Cells Expressing an NKG2D Chimeric Antigen Receptor in Children, Adolescents and Young Adults with Advanced Sarcoma
Sponsor: Hospital Universitario La Paz (Hospital/Clinic/Other health care facility). Phase: Human Pharmacology (Phase I)- First administration to humans. Countries: Spain (ongoing, recruiting).
Therapeutic area(s): Diseases [C] - Neoplasms [C04]
Gender: Female, Male. Age: 0-17 years, 18-64 years. Enrolment: 18.
Status: Ongoing, recruiting. Start date (EU): 2024-01-10. Decision date: 2024-04-15. Results received: No. Last updated: 2026-07-24.

Condition(s): Sarcoma
Product: CART45RA-NKG2D CELLS

Primary endpoint: The occurrence of Dose-limiting toxicities (DLTs) in all patients during the study treatment, until 28 days after the last study IV treatment administration and the Maximum Tolerated Dose (MTD) of NKG2D-CAR memory T cells.
Endpoint(s): Rate of NKG2D-CAR T cells persistence in peripheral blood., Rate of NKG2D-CAR T cells persistence in the tumor and metastasis site., Rate of NKG2DL positive expression on primary sarcoma samples., Cytokine determination in the serum of patients., Obtain primary patient-derived cancer cells from accessible sarcomas, Identify the DNA methylation profile of NKG2DL (MICA, MICB AND ULBPS 1-3) in primary sarcoma samples and DNA methylation profile of NKG2D-T cells before and after infusion., Evaluate the presence of soluble NKG2DL and ANTI-MICA antibodies in the serum of patients under therapy., Analysis of patient peripheral blood immune cell subpopulations, Incidence and severity of adverse events (clinical and laboratory)., Incidence of SAEs., Performance status.

Source: https://euclinicaltrials.eu/ctis-public/view/2024-513514-35-00